EU clinical trial 2024-516077-72-02: Safety and Efficacy of Neoadjuvant immunotherapy with Durvalumab (MEDI 4736) in combination with neoadjuvant chemotherapy (Gemcitabin/Cisplatin or Gemcitabin/Carboplatin) in patients with operable, high-risk, localized urothelial carcinoma of the upper urinary tract. iNDUCT - GETUG V08
Protocol code: CIVI/2018/NH-01
Sponsor: Centre Hospitalier Universitaire De Nimes (Hospital/Clinic/Other health care facility). Phase: Therapeutic exploratory (Phase II). Countries: France (authorised, recruitment pending).
Therapeutic area(s): Diseases [C] - Neoplasms [C04]
Gender: Female, Male. Age: 18-64 years, 65+ years. Enrolment: 50.
Status: Authorised, recruitment pending. Decision date: 2024-11-28. Results received: No. Last updated: 2024-11-28.

Condition(s): The patient has a histologically-confirmed (ureteroscopic biopsy) or cytologically(urine cytology)-confirmed diagnosis of high-grade urothelial carcinoma of the renal pelvis or ureter.
Product: IMFINZI 50 mg/mL concentrate for solution for infusion., CARBOPLATINE MEDAC 10 mg/mL, solution à diluer pour perfusion, CISPLATINE VIATRIS 1 mg/1 ml, solution à diluer pour perfusion, Gemcitabine Accord 100 mg/ml koncentrátum oldatos infúzióhoz

Primary endpoint: In each cohort and independently the rate of patients who achieved a pathological complete response (PCR) after surgery will be assessed. Pathological complete response (PCR) is defined as no residual signs of viable tumor cells in tissue samples removed during surgery after treatment (yPT0). To find out if there is a pathologic complete response, a pathologist will perform an evaluation of the tissue samples under a microscope to see if there are still cancer cells left after the treatment.
Endpoint(s): In each cohort and independently: Rate of patients showing pathological partial response (PaR). PaR is defined as downstaging to neoadjuvant pathologic stage groups ≤ ypT1N0M0 (ypT0-Ta-Tis/T1 disease). The rate of patients with PaR will be calculated on the subpopulation of patients with ureteroscopic biopsy at diagnosis., In each cohort and independently: Assessment of safety and tolerability by analysing and interpreting Common Terminology Criteria for Adverse Event (CTCAE) until surgery using the National Cancer Institute, Division of Cancer Treatment and Diagnosis (DCTD) listing of CTCAE (NCI CTCAE V5.0)., In each cohort and independently:The overall survival, bladder recurrence, dissemination will be collected at 2 years follow-up after surgery.

Source: https://euclinicaltrials.eu/ctis-public/view/2024-516077-72-02